EU clinical trial 2024-518223-29-00: A randomized, non-comparative, phase II study investigating the best epidermal growth factor receptor tyrosine kinase inhibitor (EGFR-TKI) sequence in advanced or metastatic non-small-cell lung cancer (NSCLC) harboring EGFR mutations
Protocol code: CAPLAND
Sponsor: Fondazione Ricerca Traslazionale (Laboratory/Research/Testing facility). Phase: Therapeutic exploratory (Phase II). Countries: Spain (authorised, recruitment pending), Italy (ongoing, recruitment ended).
Therapeutic area(s): Diseases [C] - Neoplasms [C04]
Gender: Female, Male. Age: 18-64 years, 65+ years. Enrolment: 189.
Start date (EU): 2020-03-10. Decision date: 2025-01-21. Results received: No. Last updated: 2026-04-24.
Decision dates by country: ES: 2025-01-21, IT: 2025-01-31

Condition(s): Advanced or metastatic untreated EGFR mutation positive NSCLC
Product: Vizimpro 15 mg film-coated tablets, TAGRISSO 80 mg film-coated tablets

Primary endpoint: OS in patients treated with osimertinib first or dacomitinib first
Endpoint(s): • OS in patients treated with osimertinib first followed by dacomitinib and in patients treated with dacomitinib first followed by osimertinib • PFS at the time of study second-line therapy failure (PFS2) in patients treated with front-line osimertinib or dacomitinib; • PFS in patients treated with osimertinib first or dacomitinib first; • Response Rate (RR) with dacomitinib or osimertinib; • RR, PFS and OS with osimertinib followed by dacomitinib or with the opposite sequence in patients with u

Source: https://euclinicaltrials.eu/ctis-public/view/2024-518223-29-00